EU clinical trial 2024-518411-19-00: Phase 1/2 Study of BDC-1001 as a Single Agent and in Combination with Nivolumab in Patients with Advanced HER2-Expressing Solid Tumors
Protocol code: BBI-20201001
Sponsor: Bolt Biotherapeutics Inc. (Pharmaceutical company). Phase: Phase I and Phase II (Integrated)- Other. Countries: France (ended).
Therapeutic area(s): Diseases [C] - Neoplasms [C04]
Gender: Female, Male. Age: 18-64 years, 65+ years. Enrolment: 15.
Status: Ended. Start date (EU): 2023-12-04. End date (EU): 2025-02-14. End date: 2025-02-15. Decision date: 2024-11-14. Results received: Yes. Last updated: 2025-03-05.

Condition(s): Advanced HER2-Expressing Solid Tumors.
Product: OPDIVO 10 mg/mL concentrate for solution for infusion., BDC-1001, OPDIVO 10 mg/mL concentrate for solution for infusion., OPDIVO 10 mg/mL concentrate for solution for infusion.

Primary endpoint: Incidence of AEs and SAEs graded according to NCI CTCAE v5.0, Incidence and nature of DLTs within a 3 + 3 design, The occurrence of DLTs
Endpoint(s): Pharmacokinetic variables may include: • Cmax • Cmin • AUC0-t • AUC0-inf • CL • Vz • t½, ORR using RECIST v1.1 • DCR of confirmed CR, confirmed PR, or stable disease (SD) lasting 24 weeks (- 7 days) or more weeks following the initiation of BDC-1001 • DoR • PFS, Incidence of ADAs against BDC-1001

Source: https://euclinicaltrials.eu/ctis-public/view/2024-518411-19-00